EU clinical trial 2024-515560-30-00: A first-in-human, two-part, open-label, clinical study to assess the safety, tolerability, and activity of intravenous doses of ICT01 as monotherapy and in combination with an immune checkpoint inhibitor, in patients with advanced-stage, relapsed/refractory cancer (EVICTION Study)
Protocol code: ICT01-101
Sponsor: Imcheck Therapeutics (Pharmaceutical company). Phase: Phase I and Phase II (Integrated)- First administration to humans. Countries: Belgium (ended), France (ongoing, recruitment ended), Spain (ongoing, recruitment ended), Germany (ended).
Therapeutic area(s): Diseases [C] - Neoplasms [C04]
Gender: Female, Male. Age: 18-64 years, 65+ years. Enrolment: 325.
Start date (EU): 2020-03-05. Decision date: 2024-09-13. Results received: No. Last updated: 2026-06-08.
Decision dates by country: BE: 2024-09-16, DE: 2024-09-17, FR: 2024-09-13, ES: 2024-09-16

Condition(s): Advanced-stage, relapsed/refractory cancer
Product: KEYTRUDA 25 mg/mL concentrate for solution for infusion

Primary endpoint: Part 1: • Incidence, severity (according to National Cancer Institute [NCI]- Common Terminology Criteria for Adverse Events [CTCAE] Version 5), and relationship to study treatment of treatment-emergent adverse events (TEAEs), serious adverse events (SAEs), and TEAEs leading to discontinuation of study treatment or treatment modifications; • Incidence and severity of clinical laboratory abnormalities; • Clinically significant findings on vital signs, ECGs, and physical examinations., Part 2: • DCR according to RECIST Version 1.1 for solid tumors (complete response [CR] + partial response [PR] + stable disease [SD]); • Complete remission rate (CRR) according to the European LeukemiaNet (ELN) 2022 criteria for AML (complete remission [CR] + CR with partial hematological recovery [CRh] + CR with incomplete hematological recovery [CRi] + morphologic leukemia-free state [MLFS])., Continued treatment period: DoR according to RECIST 1.1 for solid tumor or ELN 2022 criteria for AML;
Endpoint(s): Part I: Incidence of dose-limiting toxicities (DLTs), other safety measures, and biomarker data. • PK parameters of ICT01 • Presence or absence of anti-ICT01 antibodies in blood.• Disease control rate (DCR) and objective response rate (ORR) according to Response Evaluation Criteria In Solid Tumors, immunotherapy RECIST, Response Evaluation Criteria In Lymphoma, or as per disease-specific standards, Part 2: • Differential benefit–risk, as measured by the totality of safety, lab, PK, PD and efficacy data. • Incidence, severity (according to CTCAE V5), and relationship of TEAEs, SAEs and TEAEs leading to discontinuation/modification of study treatment • Incidence and severity (according to CTCAE V5.0) of clinical lab abnormalities; • CS findings on VS, ECGs, and physical exams. • PK parameters of ICT01, including Cmax, AUC, t½, and clearance. • Presence/absence of anti-ICT01 blood Ab, Continued treatment period: • Presence or absence of anti-ICT01 antibodies in blood.• Incidence, severity (according to NCI CTCAE Version 5.0), and relationship to study treatment of TEAEs, SAEs, and TEAEs leading to discontinuation of study treatment or treatment modifications

Source: https://euclinicaltrials.eu/ctis-public/view/2024-515560-30-00